EU clinical trial 2026-525200-99-00: Clinical trial to evaluate the safety, tolerability and effectiveness of a medicinal nasal insert in the treatment of chronic hay fever.- Inspicare
Protocol code: protocol_v2
Sponsor: Dianosic (Pharmaceutical company). Phase: Human Pharmacology (Phase I)- First administration to humans. Countries: Netherlands (authorised, recruitment pending).
Therapeutic area(s): Diseases [C] - Respiratory Tract Diseases [C08]
Gender: Female, Male. Age: 18-64 years, 65+ years. Enrolment: 25.
Status: Authorised, recruitment pending. Decision date: 2026-05-21. Results received: No. Last updated: 2026-05-21.

Condition(s): Chronic allergic rhinitis

Source: https://euclinicaltrials.eu/ctis-public/view/2026-525200-99-00